EU clinical trial 2024-511940-20-00: A multicenter, randomized, active-controlled, double-blind, double-dummy, parallel group clinical trial, investigating the efficacy, safety, and tolerability of continuous subcutaneous ND0612 infusion in comparison to oral IR-LD/CD in subjects with Parkinson’s disease experiencing motor fluctuations (BouNDless)
Protocol code: ND0612-317
Sponsor: Neuroderm Ltd. (Pharmaceutical company). Phase: Therapeutic confirmatory (Phase III). Countries: Austria (ended), Slovakia (ongoing, recruitment ended), Belgium (ended), Spain (ongoing, recruitment ended), Poland (ended), Portugal (ended), Czechia (ended), France (ended), Italy (ongoing, recruitment ended).
Therapeutic area(s): Diseases [C] - Nervous System Diseases [C10]
Gender: Female, Male. Age: 18-64 years, 65+ years. Enrolment: 156.
Start date (EU): 2020-02-05. Decision date: 2024-05-17. Results received: No. Last updated: 2026-06-29.
Decision dates by country: AT: 2024-05-22, CZ: 2024-05-21, IT: 2024-06-18, PL: 2024-05-17, SK: 2024-05-20, FR: 2024-06-11, ES: 2024-05-22, BE: 2024-05-21, PT: 2024-05-17

Condition(s): Parkinson's disease
Product: PLACEBO TO ND0612. Solution for infusion, subcutaneous use. Major ingredients: Sodium Phosphate Dibasic Anhydrous, Sodium Phosphate Monobasic Dihydrate, LArginine, Ascorbic Acid, PLACEBO FOR LD/CD Capsules (white): capsules, oral use, Major ingredients: Carbidopa–Levodopa placebo tablet (White) is composed of a yellow placebo tablet and pharmacopeial grade microcrystalline cellulose Avicel PH-102) filled into size DB AA white opaque gelatin capsules., IR-LD/CD, ND0612, PLACEBO for LD/CD Capsules (grey):capsules, oral use, Major ingredients: Carbidopa–Levodopa placebo capsule is composed of pharmacopoeia grade microcrystalline cellulose (Avicel PH-102) filled into size DB AA grey opaque capsules. It corresponds to comparator grey capsules.

Primary endpoint: The primary endpoint is the change from Baseline to the end of the DBDD Maintenance Period in the mean daily "ON" time without troublesome dyskinesia adjusted to subject's waking hours and normalized to 16 waking hours, based on subject's "ON/OFF" diary assessments on the 3 consecutive days before the visit.
Endpoint(s): The key secondary efficacy endpoint is the change from Baseline to the end of the DBDD Maintenance Period (DB W12) in the mean daily "OFF" time adjusted to subject's waking hours and normalized to 16 waking hours, based on subject's "ON/OFF" diary assessments on the 3 consecutive days before the visits.

Source: https://euclinicaltrials.eu/ctis-public/view/2024-511940-20-00